EU clinical trial 2024-516825-30-00: A phase II, multicenter, open-label, non-comparative study to evaluate the pharmacokinetics, pharmacodynamics, and tolerability of osilodrostat in children and adolescent patients with Cushing's disease
Protocol code: CLCI699C2203
Sponsor: Recordati AG (Pharmaceutical company). Phase: Therapeutic exploratory (Phase II). Countries: France (ended), Belgium (ended), Italy (ended).
Therapeutic area(s): Diseases [C] - Hormonal diseases [C19]
Gender: Female, Male. Age: 0-17 years. Enrolment: 12.
Status: Ended. Start date (EU): 2020-09-21. End date (EU): 2025-10-13. Decision date: 2024-10-31. Results received: Yes. Last updated: 2025-03-17.
Decision dates by country: BE: 2024-10-31, IT: 2024-11-05, FR: 2024-11-22

Condition(s): Cushing's disease
Product: Isturisa 1 mg film-coated tablets, Isturisa 5 mg film-coated tablets, Isturisa 10 mg film-coated tablets

Primary endpoint: Pharmacokinetic parameters of osilodrostat
Endpoint(s): Proportion of patients with normal mUFC, mUFC absolute values and change from baseline, Safety and tolerability

Source: https://euclinicaltrials.eu/ctis-public/view/2024-516825-30-00